EU clinical trial 2023-507399-27-00: A Phase 3, Multicenter, Randomized, Double-Blind, Placebo-Controlled Study to Assess the Efficacy and Safety of REL-1017 as Adjunctive Treatment for Major Depressive Disorder - SM-1
Protocol code: REL-1017-305
Sponsor: Mggm LLC (Laboratory/Research/Testing facility). Phase: Therapeutic confirmatory (Phase III). Countries: Italy (ended).
Therapeutic area(s): Psychiatry and Psychology [F] - Mental Disorders [F03]
Gender: Female, Male. Age: 18-64 years. Enrolment: 130.
Status: Ended. Start date (EU): 2024-12-04. End date (EU): 2025-01-31. End date: 2025-02-01. Decision date: 2024-05-08. Results received: No. Last updated: 2024-11-19.

Condition(s): Major Depression
Product: identical tablets containing Lactose Monohydrate Fast-F lo, Cellulose Microcrystalline PH-102, Croscarmellose Sodium, Colloidal Silicon Dioxide-Cabot, and Magnesium Stearate 5712.

Primary endpoint: Decrease from Baseline to Day 28 of the MADRS10 total score in REL-1017 compared to placebo in participants with inadequate response to ongoing ADT
Endpoint(s): Decrease from Baseline to Day 7 of the MADRS10 total score, MADRS10 response rate (improvement ≥50% compared with total Baseline score) at Day 28, MADRS10 remission rate (total score ≤10) at Day 28, Decrease from Baseline to Day 28 of the CGI-S score, Effect of the following covariates on primary endpoint: MADRS10 total score as a function of severity at baseline (MADRS baseline >35) tachyphylaxis/tolerance (yes/no), TRD (yes/no), time since first diagnosis of MDD, sex and age., CGI-I score at Day 7 and Day 28, Decrease from Baseline to Day 28 in MADRS10 component scores, Change from Baseline in DSST, Change from Baseline in ASEX, Change from Baseline to Day 28 of each Sheehan Disability Scale (SDS) domain score, Change from Screening to Day 28 of the Hamilton Anxiety Depression Scale (HAM-A) total score, Change from Baseline to Day 28 of potential blood markers of MDD or treatment outcome, Treatment-emergent adverse events (TEAEs), • Vital signs and weight • Physical examination • Clinical laboratory parameters (chemistry, hematology, and urinalysis), C-SSRS (Columbia Suicide Severity Rating Scale) Change from baseline at each assessment point. Safety end point and used to identify behaviors that may be indicative of an individual's intent to commit suicide and to guide adoption of appropriate measures, Evaluate the effects on QT interval with Fridericia's correction (QTcF) at Day 28, PK evaluation at Day 28

Source: https://euclinicaltrials.eu/ctis-public/view/2023-507399-27-00